EU clinical trial 2024-515848-23-00: Tuvusertib (M1774) in Participants with Metastatic or Locally Advanced Unresectable Solid Tumors (DDRiver Solid Tumors 301)
Protocol code: MS201924_0001
Sponsor: Merck Healthcare KGaA (Pharmaceutical company). Phase: Human Pharmacology (Phase I)- First administration to humans. Countries: Spain (ongoing, recruitment ended).
Therapeutic area(s): Diseases [C] - Neoplasms [C04]
Gender: Female, Male. Age: 18-64 years, 65+ years. Enrolment: 27.
Status: Ongoing, recruitment ended. Start date (EU): 2022-03-18. Decision date: 2024-08-06. Results received: No. Last updated: 2026-01-13.

Condition(s): Metastatic or Locally Advanced Unresectable Solid Tumors

Source: https://euclinicaltrials.eu/ctis-public/view/2024-515848-23-00